EU clinical trial 2024-513439-25-00: A Phase 1 Study of JNJ-87562761 in Relapsed/Refractory Multiple Myeloma
Protocol code: 87562761MMY1001
Sponsor: Janssen Cilag International (Pharmaceutical company). Phase: Human Pharmacology (Phase I)- First administration to humans. Countries: Spain (ended).
Therapeutic area(s): Diseases [C] - Neoplasms [C04]
Gender: Female, Male. Age: 18-64 years, 65+ years. Enrolment: 15.
Status: Ended. Start date (EU): 2025-04-30. End date (EU): 2026-05-22. Decision date: 2024-10-11. Results received: No. Last updated: 2025-12-11.

Condition(s): Relapsed/Refractory Multiple Myeloma

Source: https://euclinicaltrials.eu/ctis-public/view/2024-513439-25-00